EU clinical trial 2023-505500-37-00: Echec-MAT - A combination of antibiotics to improve neonatal mortality and morbidity for pregnancies complicated with previable labour and intact membranes: an open multiple center, randomized, and controlled trial
Protocol code: APHP220670
Sponsor: Assistance Publique Hopitaux De Paris (Hospital/Clinic/Other health care facility). Phase: Therapeutic confirmatory (Phase III). Countries: France (authorised, recruitment pending).
Therapeutic area(s): Diseases [C] - Female Urogenital Diseases and Pregnancy Complications [C13]
Gender: Female. Age: 18-64 years. Enrolment: 350.
Status: Authorised, recruitment pending. Decision date: 2024-09-19. Results received: No. Last updated: 2024-09-19.

Condition(s): Pregnant women with singleton pregnancies hospitalized for threatened late miscarriage with intact membranes
Product: CEFTRIAXONE VIATRIS 1 g, poudre pour solution injectable, Clarithromycine EG 500 mg comprimés pelliculés, MÉTRONIDAZOLE ARROW 500 mg, comprimé pelliculé sécable

Primary endpoint: Composite criterion combining late miscarriage, perinatal mortality, and/or severe neonatal morbidity occurring before hospital discharge, including: 1-Late miscarriage, Perinatal mortality, Bronchopulmonary dysplasia, Sepsis proven by blood culture, Intraventricular hemorrhage ≥ Grade 3, Periventricular leukomalacia ≥ Grade 2, Necrotizing enterocolitis at stage ≥ 2 according to Bell's classification
Endpoint(s): Each item of the composite criterion: 1-Neonatal mortality and late miscarriage, Bronchopulmonary dysplasia according to international recommendations (described by Jobe and Bancalari), diagnosed at discharge or at a corrected age of 36 6/7 weeks of gestation., Sepsis proven by culture, diagnosed by a combination of clinical signs and a positive blood culture, Intraventricular hemorrhage ≥ Grade 3 and/or periventricular leukomalacia, diagnosed by repeated transfontanellar ultrasounds (according to the classification of Vries and Ment), Necrotizing enterocolitis ≥ Stage 2, using Bell's classification.

Source: https://euclinicaltrials.eu/ctis-public/view/2023-505500-37-00